EU clinical trial 2024-517704-10-00: POST-SURGICAL LIQUID BIOPSY - GUIDED TREATMENT OF STAGE III AND HIGH-RISK STAGE II COLON CANCER PATIENTS - THE PEGASUS TRIAL
Sponsor: IFOM Istituto Fondazione Di Oncologia Molecolare Ets In Breve Ifom Ets (Laboratory/Research/Testing facility). Phase: Therapeutic exploratory (Phase II). Countries: Spain (ongoing, recruitment ended), Italy (ongoing, recruitment ended).
Therapeutic area(s): Diseases [C] - Neoplasms [C04]
Gender: Female, Male. Age: 18-64 years, 65+ years. Enrolment: 156.
Status: Ongoing, recruitment ended. Start date (EU): 2024-09-30. Decision date: 2024-09-30. Results received: No. Last updated: 2024-10-14.
Decision dates by country: IT: 2024-10-14, ES: 2024-09-30

Condition(s): Colon cancer
Product: CAPECITABINE, OXALIPLATIN, FLUOROURACIL, IRINOTECAN, CAPECITABINE

Primary endpoint: Number of post-surgery false negative cases after a double ctDNA-negative detection, defined as cases that become positive at subsequent interventional LB and/or that experience radiological relapse within 2 years.
Endpoint(s): Disease-Free Survival (DFS) at 2 and 3-years, Overall Survival (OS) at 5- years., Safety and tolerability according to CTCAE version 5.0., Number of patients experiencing ctDNA seroconversion (i.e. ctDNA+ that become ctDNA-) after any chemotherapy regimen remaining disease free at 2 and 3 years., Assessment of QLQ-C30 and CR-29 EORTC questionnaires.

Source: https://euclinicaltrials.eu/ctis-public/view/2024-517704-10-00